EU clinical trial 2023-504361-23-00: Phase 1 Study of AMG 509 in Subjects With Metastatic Castration-Resistant Prostate Cancer
Protocol code: 20180146
Sponsor: Amgen Inc. (Pharmaceutical company). Phase: Human Pharmacology (Phase I)- First administration to humans. Countries: Spain (ongoing, recruiting), Germany (ongoing, recruiting), Portugal (ongoing, recruiting).
Therapeutic area(s): Diseases [C] - Neoplasms [C04]
Gender: Male. Age: 18-64 years, 65+ years. Enrolment: 61.
Status: Ongoing, recruiting. Start date (EU): 2023-03-30. Decision date: 2024-05-31. Results received: No. Last updated: 2026-03-26.
Decision dates by country: DE: 2024-06-03, PT: 2024-06-03, ES: 2024-05-31

Condition(s): Metastatic Castration-Resistant Prostate Cancer (mCRPC)

Source: https://euclinicaltrials.eu/ctis-public/view/2023-504361-23-00